EU clinical trial 2023-506813-23-00: A Phase 2, double-blind, placebo-controlled, randomized, proof-of-concept study evaluating LSTA1 when added to standard of care (temozolomide) versus temozolomide and matching LSTA1 placebo in subjects with newly diagnosed Glioblastoma Multiforme (GBM)
Protocol code: LSTA1-GBM-2A GBM
Sponsor: Tartu University Hospital (Hospital/Clinic/Other health care facility). Phase: Therapeutic exploratory (Phase II). Countries: Estonia (ongoing, recruiting), Latvia (ongoing, recruiting), Lithuania (authorised, recruiting).
Therapeutic area(s): Diseases [C] - Neoplasms [C04]
Gender: Female, Male. Age: 18-64 years, 65+ years. Enrolment: 40.
Start date (EU): 2023-12-18. Decision date: 2023-10-17. Results received: No. Last updated: 2025-10-21.
Decision dates by country: EE: 2023-10-17, LV: 2024-02-01, LT: 2025-10-21

Condition(s): Glioblastoma Multiforme
Product: Temozolomide Accord 100 mg hard capsules., Placebo, LSTA1

Primary endpoint: Overall survival: Median time from randomization until death due to any cause
Endpoint(s): 12-month survival, 24-month survival, Median progression-free survival (PFS) based on RANO criteria PFS at 6 months, Median progression-free survival (PFS) based on RANO criteria PFS at 12 months, ORR: the number of patients with documented partial or complete response (PR or CR) based on RANO criteria, relative to the screening tumor measurement, divided by the number of patients evaluable for response., Disease control rate, Duration of response (DOR) for a subset of responding patients with measurable disease at baseline, Scores on EORTC QLQ-30

Source: https://euclinicaltrials.eu/ctis-public/view/2023-506813-23-00